EU clinical trial 2023-505414-15-00: A Phase 2b, Randomized, Double-Blind, Parallel Group, Placebo Controlled, Dose Finding study to evaluate the Efficacy, Safety, Pharmacokinetics, and Pharmacodynamics of GSK1070806 SC injection in adult participants with Moderate to Severe Atopic Dermatitis
Protocol code: 219538
Sponsor: Glaxosmithkline Research & Development Limited (Pharmaceutical company). Phase: Therapeutic exploratory (Phase II). Countries: Czechia (ended), Germany (ended), France (ended), Italy (ended), Greece (ended), Poland (ended), Spain (ended), Bulgaria (ended).
Therapeutic area(s): Diseases [C] - Skin and Connective Tissue Diseases [C17]
Gender: Female, Male. Age: 18-64 years, 65+ years. Enrolment: 72.
Status: Ended. Start date (EU): 2024-04-10. End date (EU): 2025-04-08. End date: 2025-07-23. Decision date: 2024-03-04. Results received: Yes. Last updated: 2025-08-26.
Decision dates by country: BG: 2024-03-11, FR: 2024-03-05, DE: 2024-03-05, GR: 2024-03-06, CZ: 2024-03-07, ES: 2024-06-18, PL: 2024-03-08, IT: 2024-03-11

Condition(s): Dermatitis, Atopic
Product: Locally Sourced 0.9% Sodium Chloride

Primary endpoint: Percent Change From Baseline in the Eczema Area and Severity Index (EASI) to Week 16.

Source: https://euclinicaltrials.eu/ctis-public/view/2023-505414-15-00